EU clinical trial 2024-518854-18-00: A double-blind non inferiority clinical trial to compare the nephroprotection of cilastatn versus thiosulfate in patients undergoing debulking surgery with intraoperative hyperthermic intraperitoneal chemotherapy with cisplatin.
Protocol code: FIBHGM-ECNC001-2022
Sponsor: Fundacion Para La Investigacion Biomedica Del Hospital Gregorio Maranon (Hospital/Clinic/Other health care facility). Phase: Therapeutic exploratory (Phase II). Countries: Spain (ongoing, recruiting).
Therapeutic area(s): Not possible to specify
Gender: Female, Male. Age: 18-64 years, 65+ years. Enrolment: 90.
Status: Ongoing, recruiting. Start date (EU): 2024-12-19. Decision date: 2024-10-22. Results received: No. Last updated: 2025-05-13.

Condition(s): acute kidney injury
Product: Sodium Thiosulfate Hope Pharmaceuticals 250 mg/ml solution for Injection, Imipenem/Cilastatin Kabi

Primary endpoint: Percentage of patients with renal failure at 7 days* (if there is renal damage, follow-up until postoperative day 14) measured through creatinine values and the KDIGO classification. Renal failure is defined as an increase in serum creatinine of 1.5 to 1.9 times baseline, or an increase in serum creatinine by #0.3 mg/dL (#26.5 μmol/L), or a decrease in urine output <0.5 mL/kg/hour for 6 to 12 hours.
Endpoint(s): Differences in plasma pharmacokinetic variables of cisplatin during the HIPEC procedure between cilastatin-treated and thiosulfate-treated patients, Percentage of patients experiencing serious adverse events, adverse events related to study treatment, and adverse events occurring during the study., Comparison of ARF in patients with cilastatin or thiosulfate with a total follow-up of 14 days, Comparison of urinary H202 values between patients who suffer from DR and patients who do not suffer from it., Comparison of urinary H202 values between patients who suffer DR and patients who do not., Comparison of preoperative, intraoperative and postoperative factors between patients who suffer from kidney damage and patients who do not., Comparison of urinary FasL between patients with renal damage and patients without.

Source: https://euclinicaltrials.eu/ctis-public/view/2024-518854-18-00